EU clinical trial 2023-505108-52-00: COTRIVAP - Efficacy of cotrimoxazole as a de-escalation treatment of Ventilator-Associated Pneumonia in intensive care unit. Multicentric non-inferiority randomised controlled trial
Protocol code: APHP220799
Sponsor: Assistance Publique Hopitaux De Paris (Hospital/Clinic/Other health care facility). Phase: Therapeutic confirmatory (Phase III). Countries: France (ended).
Therapeutic area(s): Diseases [C] - Bacterial Infections and Mycoses [C01]; Diseases [C] - Respiratory Tract Diseases [C08]
Gender: Female, Male. Age: 18-64 years, 65+ years. Enrolment: 628.
Status: Ended. Start date (EU): 2023-12-20. End date (EU): 2025-09-19. Decision date: 2023-07-20. Results received: No. Last updated: 2025-04-23.

Condition(s): Intensive Care, Ventilator-associated Pneumonia
Product: IMIPENEM MONOHYDRATE, MEROPENEM, OFLOXACIN, CEFEPIME, TEMOCILLIN, LEVOFLOXACIN, CIPROFLOXACIN, AMOXICILLIN, AZTREONAM, CO-TRIMOXAZOLE, ERTAPENEM, AMOXICILLIN SODIUM, CEFTRIAXONE, PIPERACILLIN SODIUM, PIPERACILLIN, CEFOTAXIME

Primary endpoint: vital status at day 28
Endpoint(s): vital status at day 28, number of mechanical ventilation-free-days from inclusion to day 28 or death., Clinical, biological and radiological cure evaluated 7 to 10 days after VAP diagnosis, defined as the combination of resolution of signs and symptoms present at enrolment, biological improvement, and improvement or lack of progression of radiological signs, as adjudicated by an independent committee (PROBE methodology), new episode of VAP with the same Enterobacteriaceae, ICU length of stay, hospital length of stay, number of antibiotic free-days from inclusion to day 28 or death., safety (rate of allergy due to antimicrobial drug), ecological impact: o evolution of rate of MDR bacterial colonization on systematic screening at enrolment until ICU discharge, diagnostic of Clostridioides difficile infection between inclusion and day 28, Vital Status at day 90

Source: https://euclinicaltrials.eu/ctis-public/view/2023-505108-52-00